EU clinical trial 2024-514248-95-00: A 52 week, randomized, double-blind, double dummy multinational, multicenter, active controlled, 2-arm parallel group trial comparing CHF 5993 100/6/12.5 µg pMDI (fixed combination of extrafine Beclomethasone Dipropionate plus Formoterol Fumarate plus Glycopyrronium Bromide) to Seretide® Evohaler® 125/25 µg pMDI (fixed combination of fluticasone propionate / salmeterol xinafoate) in adolescent subjects with asthma uncontrolled on medium doses of inhaled corticosteroids in combination with long acting ß2 agonists.
Protocol code: CLI-05993AA5-06
Sponsor: Chiesi Farmaceutici S.p.A. (Pharmaceutical company). Phase: Therapeutic confirmatory (Phase III). Countries: Italy (authorised, recruitment pending), Germany (authorised, recruitment pending), Spain (authorised, recruitment pending).
Therapeutic area(s): Diseases [C] - Respiratory Tract Diseases [C08]
Gender: Female, Male. Age: 0-17 years. Enrolment: 147.
Status: Authorised, recruitment pending. Decision date: 2025-09-26. Results received: No. Last updated: 2025-09-30.
Decision dates by country: DE: 2025-09-26, IT: 2025-09-29, ES: 2025-09-30

Condition(s): Uncontrolled Asthma
Product: IMP Placebo, Comparator Placebo, Seretide Evohaler 25 microgram/125 microgram per metered dose pressurised inhalation, suspension., CHF5993 pMDI (100) -152a

Primary endpoint: Change from baseline in pre-dose FEV1 at Week 26
Endpoint(s): Change from baseline in 2 h post-dose FEV1 at Week 26, Severe asthma exacerbation rate over the 52 weeks of treatment, Time to first severe exacerbation, Change from baseline in ACQ-7 at Week 12, Week 26 and Week 52 during study visits (using centralised spirometry);, Change from baseline in AQLQ at Week 12, Week 26 and Week 52, Change from baseline in pre-dose FEV1 at all clinical visits, Change from baseline in 2 h post-dose FEV1 at all clinical visits, Proportion of subjects classified as responders in terms of pre dose FEV1 at Week 26 and Week 52 (i.e., subjects with change from baseline in pre-dose FEV1 ≥100 mL);, Change from baseline in 48 h post-dose morning FEV1 after the last intake of study treatment at Week 52;, Change from baseline in weekly ACQ-5 over the 52 weeks of treatment, Change from baseline in home spirometry parameters over the 52 weeks of treatment, Occurrence of AEs and adverse drug reactions, Vital signs: change from baseline in systolic and diastolic blood pressure at all applicable visits, ECG parameters: change from baseline in heart rate, QTcF, PR interval and QRS interval at all applicable visits, Standard haematology and blood chemistry: change from baseline in standard haematology and blood chemistry parameters at all applicable visits

Source: https://euclinicaltrials.eu/ctis-public/view/2024-514248-95-00